EU clinical trial 2024-515572-13-00: KANDOVA - A two-part Phase Ib/IIa study to evaluate the safety and tolerability of KAND567, in combination with carboplatin therapy, and to determine the Recommended Phase II Dose (RPIID) of KAND567. An open-label, multicenter dose escalation study with an expansion cohort in women with recurrent epithelial ovarian, fallopian tube, or primary peritoneal cancer.
Protocol code: KAN0007
Sponsor: Kancera AB (Pharmaceutical company). Phase: Phase I and Phase II (Integrated)- Other. Countries: Denmark (ended), Norway (ended), Sweden (ended).
Therapeutic area(s): Diseases [C] - Neoplasms [C04]
Gender: Female. Age: 18-64 years, 65+ years. Enrolment: 30.
Status: Ended. Start date (EU): 2023-04-26. End date (EU): 2025-04-03. Decision date: 2024-10-01. Results received: Yes. Last updated: 2025-03-13.
Decision dates by country: NO: 2024-10-03, DK: 2024-10-03, SE: 2024-10-01

Condition(s): Recurrent epithelial ovarian, fallopian tube, or primary peritoneal cancer.
Product: Carboplatin Accord 10 mg/ml koncentrat till infusionsvätska, lösning, Carboplatin Actavis 10 mg/ml koncentrat till infusionsvätska, lösning, Carboplatin Accord 10 mg/ml konsentrat til infusjonsvæske, oppløsning, Carboplatin Ebewe 10 mg/ml koncentrat till infusionsvätska, lösning, Carboplatin ”Accord”, koncentrat til infusionsvæske, opløsning, Carboplatin Accord 10 mg/ml koncentrat till infusionsvätska, lösning, Carboplatin ”Accord”, koncentrat til infusionsvæske, opløsning, Carboplatin Accord 10 mg/ml konsentrat til infusjonsvæske, oppløsning, Carboplatin ”Accord”, koncentrat til infusionsvæske, opløsning, Carboplatin Fresenius Kabi, Carboplatin Accord 10 mg/ml koncentrat till infusionsvätska, lösning, Carboplatin Fresenius Kabi 10 mg/ml konsentrat til infusjonsvæske, oppløsning, Carboplatin ”Actavis”, koncentrat til infusionsvæske, opløsning, Carboplatin ”Accord”, koncentrat til infusionsvæske, opløsning, Carboplatin Accord 10 mg/ml konsentrat til infusjonsvæske, oppløsning, Carboplatin Accord 10 mg/ml konsentrat til infusjonsvæske, oppløsning, Carboplatin "Ebewe", koncentrat til infusionsvæske, opløsning, Carboplatin Accord 10 mg/ml koncentrat till infusionsvätska, lösning

Primary endpoint: Occurrence of adverse events (AEs), serious adverse events (SAEs), and dose limiting toxicities (DLTs)., The safety endpoint parameters are frequency and severity of AEs, vital signs, electrocardiography (ECG), and the results of laboratory safety tests and urinalysis., RPIID of KAND567 in combination with carboplatin therapy will be determined based on safety and tolerability (Part 1/Phase Ib only).
Endpoint(s): ORR at Weeks 12 and 18, according to RECIST 1.1 and GCIG definitions, i.e., best overall response in subjects with measurable disease, or without measurable disease evaluable by CA 125., Progression-free survival (PFS) at Weeks 12 and 18., Overall survival (OS) at end of study., Disease control rate (DCR) (Complete response [CR] + Partial response [PR] + Stable disease [SD]) at Weeks 12 and 18., Duration of response according to RECIST 1.1 and GCIG definitions (time from documentation of tumor response to disease progression)., KAND567 PK drug concentration data will be graphically visualized together with normalized PK drug concentration data from the previous KAN0001 study (i.e., no formal PK analysis will be performed)., Change in pain score, as measured by the Numeric Rating Scale (NRS) from baseline (Week 1) to Weeks 4, 7, 10, 13, 16 and 20.

Source: https://euclinicaltrials.eu/ctis-public/view/2024-515572-13-00